EU clinical trial 2025-525083-14-00: SCARFREE-001: A Phase 2 Dose-Finding and Proof-of-Concept Study of Intradermal Verteporfin for Scar Prevention in Open and Closed Surgical Wounds
Sponsor: Odense University Hospital (Hospital/Clinic/Other health care facility). Phase: Therapeutic exploratory (Phase II). Countries: Denmark (authorised, recruitment pending).
Therapeutic area(s): Analytical, Diagnostic and Therapeutic Techniques and Equipment [E] - Therapeutics [E02]
Gender: Female, Male. Age: 18-64 years, 65+ years. Enrolment: 12.
Status: Authorised, recruitment pending. Decision date: 2026-05-13. Results received: No. Last updated: 2026-05-13.

Condition(s): Scar formation following surgical wounds
Product: VERTEPORFIN, SALINE

Primary endpoint: Closed wound endpoint: Difference in scar quality between three verteporfin doses (0.5, 1.0, 2.0 mg/mL) and placebo, assessed in sutured incision segments using the Observer component of the Patient and Observer Scar Assessment Scale (POSAS) at 3 months., Open wound endpoint: Difference in scar quality between the same three doses and placebo, assessed in punch biopsy wounds, also using Observer POSAS at 3 months.
Endpoint(s): Safety and Tolerability: Incidence, severity, and type of local and systemic adverse events (AEs)., Manchester Scar Scale (MSS) based on standardized clinical photographs and ultrasound-based measurement of scar thickness, Time to Complete Epithelialization (Open Model Only): Days from punch biopsy creation to complete re-epithelialization., Patient Satisfaction: Patient's subjective assessment and satisfaction with each treated area using SCAR-Q Appearance Scale and SCAR-Q Symptom Scale

Source: https://euclinicaltrials.eu/ctis-public/view/2025-525083-14-00